EU clinical trial 2024-518019-20-00: Effects of mesenchymal stem cells administration on organ failure during septic shock: Phase II randomized comprator-controlled study CHOC-MSC
Sponsor: CHRU De Nancy (Hospital/Clinic/Other health care facility). Phase: Therapeutic exploratory (Phase II). Countries: France (authorised, recruiting).
Therapeutic area(s): Diseases [C] - Bacterial Infections and Mycoses [C01]
Gender: Female, Male. Age: 18-64 years, 65+ years. Enrolment: 66.
Status: Authorised, recruiting. Start date (EU): 2021-10-19. Decision date: 2024-12-06. Results received: No. Last updated: 2025-06-23.

Condition(s): La population concernée est celle des patients hospitalisés en réanimation présentant un choc septique d’origine communautaire très sévère (≥ 2 défaillances d’organes autres qu’hémodynamiques) depuis moins de 12 heures.
Product: VIALEBEX 40 g/L, solution pour perfusion, Mesenchymal Stem Cells (MSCs), SODIUM CHLORIDE, ALBUMIN

Primary endpoint: The primary endpoint is the SOFA score (clinico-biological severity score ranging from 0 to 24 points) at D7 (or the day of death or discharge from intensive care if before D7) compared with that observed in patients in the control group.
Endpoint(s): For objective 1: Time to SOFA < 3 (in days). Start date = date of arrival in the intensive care unit, end date = D7., For the 2nd objective: i) Number of days living without respiratory assistance at D28, ii) Number of days living without catecholamines at D28, iii) Number of days living without extra-renal purification at D28, iv) Length of stay in intensive care and in hospital,, For the 3rd objective: i) mortality at D28, ii) mortality at D90, For the 4th objective i) Transient fall in PaO2/FiO2 ratio (or arterial desaturation >5%) within 2 hours of MSC administration ii) Transient rise in mean pulmonary arterial pressure (>5 mHg) within 2 hours of MSC administration iii) Shivering, hyperthermia within 2 hours of MSC administration iv) occurrence of pulmonary embolism within 2 hours of MSC administration v) occurrence of adverse events up to 90 days after MSC injection.

Source: https://euclinicaltrials.eu/ctis-public/view/2024-518019-20-00